EU clinical trial 2024-515228-36-00: A Non-Randomized, Open-Label Study to Assess the Reduction of Human Papillomavirus (HPV) Viral Infectivity and Transmission in HPV16/18-Positive Women Before and After Vaccination with 9vHPV, a Multivalent L1 Virus-like Particle Vaccine, Evaluated in Cervical, Anal, Vulvar, Urine and Oral Samples Obtained After One, Two, and Three Vaccine Doses (RIFT-HPV1/RIFT-HPV2).
Sponsor: Bellvitge University Hospital, Fundacio Institut D'Investigacio Biomedica De Bellvitge IDIBELL (Hospital/Clinic/Other health care facility, Laboratory/Research/Testing facility). Phase: Therapeutic use (Phase IV). Countries: Spain (ongoing, recruiting).
Therapeutic area(s): Diseases [C] - Virus Diseases [C02]
Gender: Female. Age: 18-64 years. Enrolment: 90.
Status: Ongoing, recruiting. Start date (EU): 2022-08-18. Decision date: 2024-07-15. Results received: No. Last updated: 2025-11-24.

Condition(s): Evaluation of the reduction of HPV infectivity and transmission before and after vaccination with 9vHPV
Product: Gardasil 9 suspension for injection in a pre-filled syringe. Human Papillomavirus 9-valent Vaccine (Recombinant, adsorbed)

Primary endpoint: In-vitro infectivity evaluation (by expression of E1^E4 HPV biomarker in HaCaT keratinocytes) of cervical, anal, vulvar, urine and oral samples collected before and after 9vHPV vaccination., Detection of HPV 6/11/16/18/31/33/45/52/58 L1 antibodies in cervical, anal, vulvar, urine and oral samples collected before and after 9vHPV vaccination, using: -ELISA for types 16 and 18 in samples from RIFT-HPV 1 and 2 study cohorts, -cLIA for all 9vHPV-covered types in samples from RIFT-HPV 1 study cohort. This endpoint will allow associating the reduction in viral infectivity with the presence of neutralizing antibodies., -HPV16/18 virion detection (using ELISA, electronic microscopy) and HPV DNA detection and genotyping (using Anyplex/Allplex HPV28) in cervical, anal, vulvar, urine and oral samples collected before and after 9vHPV vaccination. This endpoint will allow to identify samples of subjects with a nonproductive viral infection or undergoing natural clearance, and distinguish them from samples of subjects with productive but reduced infection due to 9vHPV vaccination.
Endpoint(s): -HPV 6/11/16/18/31/33/45/52/58 L1 antibody titration in serum samples collected before and after 9vHPV vaccination, using: -ELISA for types 16 and 18 in samples from RIFT-HPV 1 and 2 study cohorts, -cLIA for all 9vHPV-covered types in samples from RIFT-HPV 1 study cohort.

Source: https://euclinicaltrials.eu/ctis-public/view/2024-515228-36-00